EU clinical trial 2024-510712-75-00: COTESARC : A multicentre, open-label, Phase I-II study evaluating the combination of a MEK inhibitor and a PDL1 inhibitor in pediatric and adult patients with locally advanced and/or metastatic soft tissue sarcoma
Protocol code: ET-19036
Sponsor: Centre Leon Berard (Hospital/Clinic/Other health care facility). Phase: Phase I and Phase II (Integrated)- Other. Countries: France (ongoing, recruiting).
Therapeutic area(s): Diseases [C] - Neoplasms [C04]
Gender: Female, Male. Age: 0-17 years, 18-64 years, 65+ years. Enrolment: 80.
Status: Ongoing, recruiting. Start date (EU): 2020-02-12. Decision date: 2024-12-04. Results received: No. Last updated: 2026-07-27.

Condition(s): advanced / metastatic
Product: Tecentriq 1 200 mg concentrate for solution for infusion, Cotellic 20 mg film-coated tablets, COBIMETINIB

Primary endpoint: Safety run in Incidence of severe toxicities (ST) during the 1st cycle of treatment, Phase II part Progression Free rate after 16 weeks of treatment (PFR16w)
Endpoint(s): Nature, frequency and severity of AE according to NCI-CTCAE V5.0, ORR at 8 and 16 weeks according to RECIST V1.1 and iRECIST Duration of response; PFS; OS

Source: https://euclinicaltrials.eu/ctis-public/view/2024-510712-75-00